EU clinical trial 2023-505825-15-00: A Phase II, Randomized, Double-Blind, Placebo-Controlled, Multicenter Study to Evaluate the Efficacy, Safety, and Pharmacokinetics of Obinutuzumab in Adolescent Patients with Active Class III or IV Lupus Nephritis, Including an Evaluation of Open Label Safety and PK in a Cohort of Pediatric Patients (Aged 5 To < 12)
Protocol code: WA42985
Sponsor: F. Hoffmann-La Roche AG (Pharmaceutical company). Phase: Therapeutic exploratory (Phase II). Countries: Spain (ongoing, recruiting), France (ongoing, recruiting), Italy (ongoing, recruiting), Poland (ongoing, recruiting).
Therapeutic area(s): Diseases [C] - Immune System Diseases [C20]
Gender: Female, Male. Age: 0-17 years. Enrolment: 10.
Status: Ongoing, recruiting. Start date (EU): 2021-10-29. Decision date: 2024-08-27. Results received: No. Last updated: 2026-04-20.
Decision dates by country: PL: 2024-10-05, ES: 2024-08-27, IT: 2024-10-15, FR: 2024-09-10

Condition(s): Lupus Nephritis (LN)
Product: Gazyvaro 1,000 mg concentrate for solution for infusion., CellCept 1 g/5 ml powder for oral suspension, Gazyvaro Placebo, Myfenax 500 mg film-coated tablets

Primary endpoint: 1. Proportion of participants who achieve a complete renal response (CRR) at Week 76 (AP), 2. Incidence, nature, and severity of AEs, Incidence of laboratory or vital sign abnormalities from baseline to Week 76 analysis and serum concentrations of obinutuzumab at specified timepoints (PP)
Endpoint(s): 1. Proportion of adolescent participants achieving a CRR at Weeks 24 and 52 (AP), 2. Proportion of participants who achieve CRR with successful prednisone taper at Week 76, defined as achievement of CRR (as above) at Week 76 with the following: – No receipt of prednisone > 7.5 mg/day (or equivalent) from Week 64 through Week 76, 3. Proportion of participants who achieve a partial renal response (PRR) at Week 76. PRR is defined as achievement of all of the following: – ≥ 50% reduction in UPCR from baseline – UPCR < 1 g/g (or < 3 g/g if the baseline UPCR was ≥ 3 g/g) – eGFR ≥ 85% of baseline – No occurrence of intercurrent events, 4. Proportion of adolescent participants achieving an overall response (CRR or PRR) at Weeks 24, 52, and 76 (AP), 5. Change in urinary protein-to-creatinine ratio (UPCR) from baseline to Week 76 (AP), 6. Change in estimated glomerular filtration rate (eGFR) from baseline to Week 76 (AP), 7. Time to onset of CRR over the course of 76 weeks (AP), 8. Proportion of participants who experience treatment failure from Week 12 to Week 76 (AP), 9. Change in anti dsDNA titers from baseline to Week 76, 10. Change in C3 complement levels from baseline to Week 76 (AP), 11. Change in C4 complement levels from baseline to Week 76 (AP), 12. Incidence, nature, and severity of adverse events, with severity determined according to National Cancer Institute Common Terminology Criteria for Adverse Events (NCI CTCAE) from baseline to Week 76 (AP), 13. Incidence of laboratory or vital sign abnormalities from baseline to Week 76 (AP), 14. Serum concentrations of obinutuzumab at specified timepoints (AP), 15. Proportion of participants achieving B-cell depletion, at specified timepoints, 16. Change in Pediatric Quality of Life Inventory-Multidimensional Fatigue scale (PedsQL)-Fatigue total score from baseline to Week 76 (AP), 17. Change in Systemic Lupus Erythematosus Disease Activity Index 2000 (SLEDAI-2K) from baseline to Week 76 (AP), 18. Change from baseline in Child Health Questionnaire-Parent Form 28 (CHQ-PF28) domain scores from baseline to Week 76 (AP), 19. Proportion of participants with anti-drug antibodies (ADA) at weeks 0, 24, 52 and 76, 20.Relationship between ADA status and efficacy, safety, pharmacodynamic, or PK endpoints, 21. Proportion of patients achieving a complete renal response (CRR) at Week 76 (PP), 22. Proportion of patients achieving an overall response, defined as achieving a complete or partial renal response (PRR) at Week 76 (PP), 23. Proportion of participants who achieve CRR with successful prednisone taper at Week 76, defined as achievement of CRR (as above) at Week 76 with the following (PP) – No receipt of prednisone > 7.5 mg/day (or equivalent) from Week 64 through Week 76, 24. Change in eGFR from baseline to Week 76 (PP), 25. Change in anti-dsDNA titers from baseline to Week 76

Source: https://euclinicaltrials.eu/ctis-public/view/2023-505825-15-00